EU clinical trial 2024-515198-91-00: A Phase II/III Multicenter Randomized, Double-Blind, Placebo-Controlled Platform Trial of Potential Disease Modifying Therapies Utilizing Biomarker, Cognitive, and Clinical Endpoints in Dominantly Inherited Alzheimer’s Disease (DIAD)
Protocol code: DIAN-TU-001
Sponsor: Washington University School Of Medicine (Educational Institution). Phase: Phase II and Phase III (Integrated). Countries: Ireland (ongoing, recruitment ended), Germany (ongoing, recruitment ended), Spain (ongoing, recruitment ended), Netherlands (ongoing, recruitment ended), Italy (ongoing, recruitment ended).
Therapeutic area(s): Diseases [C] - Nervous System Diseases [C10]
Gender: Female, Male. Age: 18-64 years, 65+ years. Enrolment: 24.
Status: Ongoing, recruitment ended. Start date (EU): 2022-12-20. Decision date: 2024-07-22. Results received: No. Last updated: 2026-08-07.
Decision dates by country: NL: 2024-07-22, IT: 2024-08-12, ES: 2024-07-24, IE: 2024-07-29, DE: 2024-07-30

Condition(s): Dominantly Inherited Alzheimer Disease (DIAD)
Product: MK-6240, E2814, Lecanemab, E2814 Placebo, PiB

Primary endpoint: The Primary Outcome is defined in the appendix, and may include biomarker, cognitive, or clinical outcomes. Comparisons will be made between active drug, mutation positive placebos, and control groups, e.g. eligible DIAN-OBS participants.
Endpoint(s): Assess safety and tolerability of each study drug in individuals who have mutations causing dominantly inherited Alzheimer's disease., Biomarker Endpoints used at interim analysis: Assess target engagement with biomarker endpoints specified for each drug based on mechanism of action. Assess AD biomarkers, including soluble biochemical measures (e.g. amyloid-beta and tau), imaging measures of pathology (e.g. amyloid and tau PET), and AD biomarker changes (e.g. atrophy measured by MRI, hypometabolism by FDG PET, and neurodegeneration measured by Neurofilament light)., Comparison between each drug and placebo in change from baseline for the following measures:a.Clinical measures obtained at baseline and annual visits will be administered at theDIAN-TU site include:-Clinical Dementia Rating™(CDR)including Clinical Dementia Rating Sum of Boxes™(CDRSB)-Clinician's diagnostic assessment-Geriatric Depression Scale(GDS)-Neuropsychiatric Inventory Questionnaire(NPI-Q)-FAS-MMSE also measured at the26week timepoint between annual visits with the below cognitive battery, b.Cognitive measures to obtained at Baseline and every 26 weeks will be administered at the DIAN-TU site or via homehealth nurse trial-certified cognitive rater include:-DIAN Memory Complaint Questionnaire (MAC-Q)-Buschke and Grober Free and Cued Selective Reminding Test Immediate Recall(FCSRT-IR)-Wechsler Memory Scale-Revised(WMS-R) Logical Memory/Paragraph Memory/Alternate Paragraphs for Logical Memory I&II-VersionsA and Alternate Paragraph for Logical Memory I&II-VersionB-Category Fluency -, b. Cognitive measures to be obtained at Baseline and every 26 weeks (~6 months) in will be administered at the DIAN-TU site or via home health nurse trial-certified cognitive rater include: Weschler Adult Intelligence Scale-Revised (WAIS-R) Digit-Symbol Substitution Test - Trailmaking Test parts A & B - Weschler Memory Scale-Revised (WMS-R) Digit Spatial Span Forward and Backward - Ambulatory Research in Cognition (ARC) smartphone-based cognitive assessments (Grids, Prices, Symbols), Imaging measures obtained in randomized drug arms include the following:a.Glucose metabolism PET imaging with FDG-PET b.Amyloid PET imaging with [11C]PiB-PET c.TauPET imaging with[18F]MK-6240 d.Structural brain measures with volumetric MRI e.Functional connectivity MRI(fc-MRI) f.Diffusion Tensor Imaging MRI,including diffusion basis spectrum imaging g.Blood flow measures by Arterial Spin Labeling (ASL)MRI h.Assessment of MRI features such as MCH, WMH, cerebral infarctions and ARIA on MRIsequence, Fluid biomarker measures that may be included as secondary or exploratory endpoints as specified in the drug-specific appendix and/or SAP, include the following: a. CSF and plasma amyloid species analyses b. CSF and plasma tau species analyses c. CSF and plasma neurofilament light chain analyses d. Additional CSF and blood biomarkers of AD, neurodegeneration, neuroinflammation, or other biomarkers, Assess longitudinal change in biomarker, cognitive and clinical measures in individuals who do not have mutations causing DIAD (mutation-negative placebo group). Additional drug-specific endpoints may be listed in each drug-specific appendix., For E2814 arm:Symptomatic Population(Cohort 1):To determine whetherE2814 is superior to placebo when is concurrently administered with lecanemab in change from Week24 to Week208 in Clinical Dementia Rating Scale Sum of Boxes(CDR-SB)Asymptomatic Population(Cohort 2):To determine whether E2814 is superior to placebo when is administered alone and then concurrently with lecanemab in change from Week0 to Week104(interim analysis)and Week208(final analysis) in CSF phosphorylated tau(ptau217/tot tau)

Source: https://euclinicaltrials.eu/ctis-public/view/2024-515198-91-00